EU clinical trial 2023-505643-39-00: A Randomized, Blinded, Placebo-Controlled, Phase 1 Single Ascending Dose Study in Healthy Adult Male Volunteers and an Open-Label Multiple Ascending Dose Study with Long-Term Extension in Pediatric SMA Participants Previously Treated with Onasemnogene Abeparvovec (Zolgensma™) to Evaluate the Safety, Tolerability, and Pharmacokinetics of BIIB115.
Protocol code: 277HV101
Sponsor: Biogen Idec Research Limited (Pharmaceutical company). Phase: Human Pharmacology (Phase I)- First administration to humans. Countries: France (ongoing, recruitment ended), Italy (ongoing, recruitment ended), Belgium (ongoing, recruitment ended), Netherlands (ongoing, recruitment ended), Poland (ongoing, recruitment ended), Germany (ongoing, recruitment ended).
Therapeutic area(s): Diseases [C] - Nervous System Diseases [C10]
Gender: Female, Male. Age: 0-17 years, 18-64 years. Enrolment: 56.
Status: Ongoing, recruitment ended. Start date (EU): 2023-07-17. Decision date: 2024-04-29. Results received: No. Last updated: 2026-03-13.
Decision dates by country: NL: 2024-04-29, FR: 2024-05-07, IT: 2024-04-29, BE: 2024-05-03, PL: 2024-05-06, DE: 2024-06-11

Condition(s): Spinal muscular atrophy
Product: BiiB115 placebo is a sterile liquid for injection. the formulation composition of the placebo is identical to that of BIIB115 drug product minus the active ingredient, BIIB115

Primary endpoint: Parts A, B and Long Term Extension (LTE): Number of Participants with Adverse Events (AEs) and Serious Adverse Events (SAEs) [Time Frame: Part A: Up to Day 393, Part B: Up to Day 720; Part B LTE: Up to Day 2520]
Endpoint(s): Parts A,B and B LTE: Concentration of BIIB115 in Cerebral Spinal Fluid (CSF) [Time Frame: Part A: Day 1 to Day 180, Part B: Days 1 and 720; Part B LTE: Day 720 to Day 2520]., Part A: Terminal Elimination Half-Life (t½) of BIIB115 in CSF. [Time Frame: Day 1 to Day 180]., Parts A,B and B LTE: Concentration of BIIB115 in Serum [Time Frame: Part A: Day 1 to Day 180, Part B: Day 1 to 720; Part B LTE: Day 720 to Day 2520]., Parts A and B: Terminal Elimination Half-Life (t½) of BIIB115 in Serum. [Time Frame: Part A: Day 1 to Day 180, Part B: Day 1 to Day 720]., Parts A and B: Area Under the Concentration-Time Curve from Time 0 to Last Measurable Concentration (AUC0-last) of BIIB115 in Serum. [Time Frame: Part A: Day 1 to Day 180, Part B: Day 1 to Day 720]., Parts A and B: Area Under the Concentration-Time Curve from Time 0 to Infinity (AUCinf) of BIIB115 in Serum. [Time Frame: Part A: Day 1 to Day 180, Part B: Day 1 to Day 720]., Parts A and B: Maximum Observed Concentration (Cmax) of BIIB115 in Serum. [Time Frame: Part A: Day 1 to Day 180, Part B: Day 1 to Day 720]., Parts A and B: Time to Reach Maximum Observed Concentration (Tmax) of BIIB115 in Serum. [Time Frame: Part A: Day 1 to Day 180, Part B: Day 1 to Day 720].

Source: https://euclinicaltrials.eu/ctis-public/view/2023-505643-39-00